EU clinical trial 2024-513298-29-00: Osteoarticular infections on equipment: impact of three probabilistic antibiotic therapy strategies on the digestive microbiota and gastrointestinal colonization with multidrug-resistant bacteria
Protocol code: 22-CONS-01
Sponsor: Centre Hospitalier Universitaire De Nice (Hospital/Clinic/Other health care facility). Phase: Therapeutic exploratory (Phase II). Countries: France (ongoing, recruiting).
Therapeutic area(s): Diseases [C] - Bacterial Infections and Mycoses [C01]
Gender: Female, Male. Age: 18-64 years, 65+ years. Enrolment: 75.
Status: Ongoing, recruiting. Start date (EU): 2026-05-26. Decision date: 2025-02-03. Results received: No. Last updated: 2025-11-03.

Condition(s): Osteoarticular infections on equipment
Product: CEFEPIME VIATRIS 2 g, poudre pour solution injectable, MABELIO 500 mg, poudre pour solution à diluer pour solution pour perfusion, Daptomycin Xellia 350 mg powder for solution for injection/infusion, Piperacillin/Tazobactam Viatris 4 g/0.5 g, powder for solution for infusion, Daptomycin Xellia 500 mg powder for solution for injection/infusion

Primary endpoint: The biodiversity of the gut microbiota will be determined from high-throughput sequencing data of bacterial 16S rDNA

Source: https://euclinicaltrials.eu/ctis-public/view/2024-513298-29-00